EU clinical trial 2024-515640-22-00: A phase IV, multicentre, open-label, single-arm study to investigate the efficacy, safety and durability of faricimab (RO6867461) in caucasian patients with polypoidal choroidal vasculopathy
Protocol code: ECR-AMD-2024-15
Sponsor: Association For Innovation And Biomedical Research On Light And Image (Laboratory/Research/Testing facility). Phase: Therapeutic use (Phase IV). Countries: Portugal (ongoing, recruiting), Spain (ongoing, recruiting), Italy (ongoing, recruiting).
Therapeutic area(s): Diseases [C] - Eye Diseases [C11]
Gender: Female, Male. Age: 18-64 years, 65+ years. Enrolment: 90.
Status: Ongoing, recruiting. Start date (EU): 2025-08-06. Decision date: 2025-06-23. Results received: No. Last updated: 2026-06-02.
Decision dates by country: IT: 2025-06-25, ES: 2025-06-26, PT: 2025-06-23

Condition(s): polypoidal choroidal vasculopathy
Product: Vabysmo 120 mg/mL solution for injection

Primary endpoint: Change from baseline in BCVA (as measured on the Early Treatment of Diabetic Retinopathy Study [ETDRS] chart at a starting distance of 4 meters) at Weeks 40, 44 or 48.
Endpoint(s): Change from baseline in BCVA (as measured on the ETDRS chart at a starting distance of 4 meters) to the last treatment visit., Change from baseline in BCVA over time., Proportion of participants gaining ≥ 15, ≥ 10, or ≥ 5 letters in BCVA from baseline over time., Proportion of participants avoiding loss of ≥ 15, ≥ 10, ≥ 5 letters in BCVA from baseline over time., Percentage of participants maintaining or achieving BCVA of 20/40 (69 letters)., Proportion of participants with complete polypoidal lesion regressions at Weeks 40, 44, or 48 and at the end of the study, Change from baseline in central subfield thickness (CST) at Weeks 40, 44 or 48., Change from baseline in CST to the end of the study., Change from baseline in CST over time., Proportion of participants with no intraretinal fluid and no subretinal fluid at Weeks 20, 40, 44, or 48 and at the end of the study., Proportion of participants with no intraretinal fluid, no subretinal fluid and no sub-RPE fluid at Weeks 20, 40, 44, or 48 and at the end of the study., Change from baseline in branch neovascular network size at 1 and 2 years., Proportion of participants on 12 weeks or more treatment intervals at the end of the study., Number of faricimab injections received from Week 20 until the end of the study., Incidence and severity of ocular adverse events (AE)., Incidence and severity of non-ocular AEs.

Source: https://euclinicaltrials.eu/ctis-public/view/2024-515640-22-00